EU clinical trial 2024-512945-18-00: A Phase 3, Open-Label, Multicenter, Extension Study to Evaluate the Long-Term Safety and Efficacy of Pegcetacoplan in Subjects with Geographic Atrophy Secondary to Age-Related Macular Degeneration
Protocol code: APL2-GA-305
Sponsor: Apellis Pharmaceuticals Inc. (Pharmaceutical company). Phase: Therapeutic confirmatory (Phase III). Countries: Spain (ended), Netherlands (ended), Italy (ended), Czechia (ended), France (ended), Germany (ended), Poland (ended).
Therapeutic area(s): Diseases [C] - Eye Diseases [C11]
Gender: Female, Male. Age: 18-64 years, 65+ years. Enrolment: 206.
Status: Ended. Start date (EU): 2021-11-30. End date (EU): 2025-06-05. End date: 2025-09-05. Decision date: 2024-09-16. Results received: No. Last updated: 2025-04-24.
Decision dates by country: CZ: 2024-09-17, DE: 2024-09-18, IT: 2024-09-23, ES: 2024-09-16, NL: 2024-09-18, PL: 2024-10-09, FR: 2024-09-18

Condition(s): Geographic Atrophy Secondary to Age-Related Macular Degeneration
Product: APL-2

Primary endpoint: Incidence and severity of ocular and systemic Aes
Endpoint(s): 1.The total area of GA lesion(s) in the study eye (in mm2) as assessed by fundus autofluorescence (FAF), 2.The rate of GA lesion growth in the study eye as assessed by fundus autofluorescence (FAF), 3.NL-BCVA score (study eye) as assessed by Early Treatment Diabetic Retinopathy Study (ETDRS) chart, 4. LL-BCVA score (study eye) as assessed by ETDRS chart, 5. Monocular maximum reading speed (study eye) corrected for number of words read incorrectly as assessed by Minnesota Reading (MNRead) charts or Radner charts, 6. Binocular maximum reading speed, corrected for number of words read incorrectly, as assessed by MNRead charts or Radner charts, 7.The number of absolute scotomatous points (study eye) assessed by mesopic microperimetry (selected participants [those who had the assessment performed in the antecedent study] only), 8. Macular sensitivity (study eye) as assessed by mesopic microperimetry (selected participants [those who had the assessment performed in the antecedent study] only), 9. Change in additional microperimetry parameters in the study eye (eg, 95% bivariate contour ellipse area [BCEA], number of points with a clinically significant decrease in mean sensitivity), 10.Mean FRI Index score, 11. NEI VFQ25 and NEI VFQ-39 (at select sites) composite score, near activity subscale score, distance activity subscale score, and NEI VFQ-25 driving subscale score

Source: https://euclinicaltrials.eu/ctis-public/view/2024-512945-18-00